EU clinical trial 2024-518645-17-00: A 52-week, multicenter, randomized, double-blind, placebo-controlled, parallel-group, flexible-adaptive, Phase 3 study to evaluate the efficacy and safety of rilzabrutinib in participants aged 10 to 65 years with sickle-cell disease
Protocol code: EFC17872
Sponsor: Sanofi-Aventis Recherche & Developpement (Pharmaceutical company). Phase: Therapeutic confirmatory (Phase III). Countries: Spain (ongoing, recruiting), France (ongoing, recruiting), Netherlands (authorised, recruitment pending), Belgium (ongoing, recruiting), Greece (ongoing, recruiting), Germany (authorised, recruitment pending), Italy (ongoing, recruiting).
Therapeutic area(s): Diseases [C] - Hemic and Lymphatic Diseases [C15]
Gender: Female, Male. Age: 0-17 years, 18-64 years. Enrolment: 58.
Start date (EU): 2025-10-07. Decision date: 2025-05-20. Results received: No. Last updated: 2026-07-07.
Decision dates by country: NL: 2025-05-26, IT: 2025-05-21, BE: 2025-05-23, DE: 2025-08-11, ES: 2025-05-20, GR: 2025-05-20, FR: 2025-05-26

Condition(s): Blood and lymphatic diseases
Product: Sar444671 placebo - matched placebo for test, Rilzabrutinib

Primary endpoint: Annualized rate of clinical VOC
Endpoint(s): Time to first clinical VOC incidence, Annualized rate of visits due to SCD-related complications as assessed by the Investigator, Annualized rate of home-managed VOCs as reported in the Sickle Cell Pain Crisis (SCPC) eDiary, Change in fatigue as measured by the PROMIS SF v1.0 Fatigue 13a total score (adults), Change in Hb levels, Change in fatigue as measured by the PedsQL Multidimensional Fatigue Scale total score (pediatric participants), Incidence of treatment emergent adverse events (TEAEs), including serious adverse events (SAEs), adverse events of special interest (AESIs) and adverse events leading to discontinuation., Incidence of potentially clinically significant laboratory, vital signs, and ECG abnormalities, Absolute number of simple and exchange blood transfusion, Number of days requiring acetaminophen, NSAID and/or short-acting opioid usage

Source: https://euclinicaltrials.eu/ctis-public/view/2024-518645-17-00